EU clinical trial 2024-518173-34-00: LAPTOP: PHASE 1/2 STUDY IN BORDELINE RESECTABLE, LOCALLY ADVANCED OR METASTATIC PANCREATIC CANCER TO ASSESS SAFETY AND POTENTIAL EFFICACY OF DUAL CHECKPOINT INHIBITION IN COMBINATION WITH GEMCITABINE AND NAB-PACLITAXEL FOLLOWED BY IMMUNE-CHEMORADIATION.
Protocol code: GI 1931
Sponsor: Region Hovedstaden (Hospital/Clinic/Other health care facility). Phase: Phase I and Phase II (Integrated)- Other. Countries: Denmark (ended).
Therapeutic area(s): Diseases [C] - Neoplasms [C04]
Gender: Female, Male. Age: 18-64 years, 65+ years. Enrolment: 40.
Status: Ended. Start date (EU): 2020-06-02. End date (EU): 2026-08-04. Decision date: 2024-10-08. Results received: No. Last updated: 2024-10-08.

Condition(s): Borderline resectable, locally advanced or metastatic pancreatic cancer (BRPC, LAPC or mPC)
Product: OPDIVO 10 mg/mL concentrate for solution for infusion., Abraxane 5 mg/ml powder for dispersion for infusion., Abraxane 5 mg/ml powder for dispersion for infusion., YERVOY 5 mg/ml concentrate for solution for infusion, GEMCITABINE HYDROCHLORIDE

Primary endpoint: Incidence of treatment-related AEs, SAEs, AEs leading to discontinuation, death, and laboratory abnormalities
Endpoint(s): Median PFS using RECIST v1.1 and PFSR at 6, 9, and 12 months, Median OS and OSR at 6 months, 1 year, and 2 years, Objective Response Rate (ORR) and median duration of response (DOR) by RECIST v1.1, Rate of downstaging to surgical resection

Source: https://euclinicaltrials.eu/ctis-public/view/2024-518173-34-00